EU clinical trial 2024-518640-20-00: Phase II: 68Ga-NODAGA-E[c(RGDyK)]2 Angiogenese PET for imaging angiogenesis in ischemic heart disease
Sponsor: Rigshospitalet (Hospital/Clinic/Other health care facility). Phase: Therapeutic exploratory (Phase II). Countries: Denmark (authorised, recruitment pending).
Therapeutic area(s): Diseases [C] - Cardiovascular Diseases [C14]; Phenomena and Processes [G] - Cell Physiological Phenomena [G04]; Analytical, Diagnostic and Therapeutic Techniques and Equipment [E] - Diagnosis [E01]
Gender: Female, Male. Age: 18-64 years, 65+ years. Enrolment: 42.
Status: Authorised, recruitment pending. Decision date: 2025-01-08. Results received: No. Last updated: 2025-01-08.

Condition(s): Chronic ischemic heart disease
Product: [68Ga]NODAGA-E[c(RGDyK)]2

Primary endpoint: Characterize the difference in myocardial angiogenesis measured with RGD-PET uptake before and after coronary revascularization
Endpoint(s): Correlation between myocardial angiogenic response (determined by RGD-PET) and changes in myocardial perfusion (82Rb-PET) after coronary revascularization., Correlation between myocardial angiogenic response after 3 weeks (determined by RGD-PET) and functional recovery and final infarct (18F-FDG-PET) size 6-8 weeks after coronary revascularization, Correlation between myocardial angiogenic response (determined by RGD-PET) and viability (18-F-FDG) before and after coronary revascularization

Source: https://euclinicaltrials.eu/ctis-public/view/2024-518640-20-00